EU clinical trial 2024-512238-13-00: HERTHENA-Lung01: A Phase 2 Randomized Open-Label Study of Patritumab Deruxtecan (U3-1402) in Subjects with Previously Treated Metastatic or Locally Advanced EGFR mutated Non-Small Cell Lung Cancer (NSCLC)
Protocol code: U31402-A-U201
Sponsor: Daiichi Sankyo Inc. (Pharmaceutical company). Phase: Therapeutic exploratory (Phase II). Countries: Germany (ended), Netherlands (ended), France (ended), Italy (ongoing, recruitment ended), Belgium (ended), Spain (ended).
Therapeutic area(s): Diseases [C] - Neoplasms [C04]
Gender: Female, Male. Age: 18-64 years, 65+ years. Enrolment: 76.
Start date (EU): 2021-02-10. Decision date: 2024-09-12. Results received: No. Last updated: 2026-03-12.
Decision dates by country: BE: 2024-09-12, DE: 2024-09-13, FR: 2024-09-17, ES: 2024-10-15, IT: 2024-09-23, NL: 2024-09-12

Condition(s): Metastatic or Locally Advanced EGFR mutated Non-Small Cell Lung Cancer (NSCLC)
Product: Patritumab deruxtecan

Primary endpoint: Objective Response Rate (ORR) as assessed by Blinded Independent Central Review (BICR) per RECIST v1.1
Endpoint(s): -Duration of Response (DoR), - Progression-free Survival (PFS), - Objective Response Rate (ORR), - Disease Control Rate (DCR), - Time to Response (TTR), - Best percentage change in the sum of diameters (SoD) of measurable tumors, - Overall Survival (OS), - Safety parameters (AEs, ECOG PS, vital signs, clinical laboratory parameters, ECG etc.), - Correlation between HER3 protein expression and efficacy, - Anti-drug antibody (ADA) status at baseline and post-baseline.

Source: https://euclinicaltrials.eu/ctis-public/view/2024-512238-13-00